EU clinical trial 2023-509498-21-00: TORNADO : RANDOMIZED PHASE II STUDY OF NEOADJUVANT CHEMOTHERAPY PLUS RETIFANLIMAB (INCMGA00012) IN PATIENTS WITH SELECTED RETROPERITONEAL SARCOMAS
Protocol code: IB 2021-01
Sponsor: Institut Bergonie (Hospital/Clinic/Other health care facility). Phase: Therapeutic exploratory (Phase II). Countries: France (ongoing, recruitment ended).
Therapeutic area(s): Diseases [C] - Neoplasms [C04]
Gender: Female, Male. Age: 18-64 years, 65+ years. Enrolment: 66.
Status: Ongoing, recruitment ended. Start date (EU): 2022-03-16. Decision date: 2024-09-02. Results received: No. Last updated: 2025-09-23.

Condition(s): Adult patients with treatment-naïve surgically non-metastatic and resectable primary retroperitoneal, limbs and trunk wall undifferentiated pleomorphic sarcomas.
Product: Retifanlimab (INCMGA00012), HOLOXAN 2000 mg, poudre pour usage parentéral, DOXORUBICINE ACCORD 2 mg/ml, solution pour perfusion

Primary endpoint: The antitumor activity of retifanlimab (INCMGA00012) when prescribed in association with neoadjuvant chemotherapy (Doxorubicin + Ifosfamide) will be assessed based on histological response defined as less than 10% of viable tumor cells on surgical sample.
Endpoint(s): Progression-free survival (PFS) is defined as the time from study treatment initiation to the first occurrence of disease progression or death (of any cause), whichever occurs first. 1- and 3-year PFS rates and median PFS will be reported., Overall Survival (OS) is defined as the time from study treatment initiation to death (of any cause). 1- and 3-year OS rates and median OS will be reported., Safety will be assessed using the Common Terminology Criteria for Adverse Events (CTCAE) from the NCI v5.0. Toxicity will be graded using the CTCAE v5.0. Adverse events, serious and non-serious, will be coded as per the MedDRA dictionary.

Source: https://euclinicaltrials.eu/ctis-public/view/2023-509498-21-00